EU clinical trial 2025-521301-40-00: Prospective, randomized, multicentre study to compare the efficacy at 52 weeks (1 year) of biosimilar teriparatide and alendronate in the prevention of new morphometric vertebral fractures and/or worsening of previous vertebral fractures in women with a clinical vertebral fracture or recent hip fracture (imminent risk of fracture) caused by bone fragility.
Sponsor: Gedeon Richter Iberica S.A. (Pharmaceutical company). Phase: Therapeutic use (Phase IV). Countries: Spain (authorised, recruitment pending).
Therapeutic area(s): Diseases [C] - Musculoskeletal Diseases [C05]
Gender: Female. Age: 65+ years. Enrolment: 127.
Status: Authorised, recruitment pending. Decision date: 2025-02-26. Results received: No. Last updated: 2025-05-19.

Condition(s): Prevention of new morphometric vertebral fractures and/or worsening of previous vertebral fractures.
Product: Terrosa 20 micrograms/80 microliters solution for injection in pre-filled pen, Acido Alendronico Aurobindo 70 mg compresse

Primary endpoint: The main evaluation criterion will be the percentage of patients with at least one new morphometric vertebral fracture (incident vertebral fractures) or the increase in severity of a known vertebral fracture (vertebral re-fracture) during the 52-week study period. For the diagnosis and grading of vertebral fractures, the Genant semi-quantitative method will be used on thoracic and lumbar radiographs.
Endpoint(s): new morphometric vertebral fractures or increased severity of a known vertebral fracture new clinical vertebral fractures; new non-vertebral fractures and new major non-vertebral fractures; change in BMD with respect to baseline; with respect to baseline; vertebral pain through the VAS-pain with respect to baseline & evaluation of therapeutic adherence; quality of life using the EQ-5D questionnaire with respect to baseline; frequency of AEs, SAEs, and AEs leading to treatment discontinuation

Source: https://euclinicaltrials.eu/ctis-public/view/2025-521301-40-00